EU clinical trial 2024-512624-11-00: An Open-Label, Systemic Gene Delivery Study to Evaluate the Safety, Tolerability and Expression of SRP-9001 in Association with Imlifidase in Subjects with Duchenne Muscular Dystrophy with Pre-existing Antibodies to rAAVrh74
Protocol code: SRP-9001-104
Sponsor: Sarepta Therapeutics Inc. (Pharmaceutical company). Phase: Human Pharmacology (Phase I)- Other. Countries: Spain (ended).
Therapeutic area(s): Diseases [C] - Musculoskeletal Diseases [C05]; Diseases [C] - Congenital, Hereditary, and Neonatal Diseases and Abnormalities [C16]
Gender: Male. Age: 0-17 years. Enrolment: 7.
Status: Ended. Start date (EU): 2023-12-15. End date (EU): 2025-10-10. Decision date: 2024-08-29. Results received: Yes. Last updated: 2025-03-18.

Condition(s): Duchenne muscular dystrophy (DMD)
Product: Idefirix 11 mg powder for concentrate for solution for infusion, Delandistrogene moxeparvovec-rokl

Primary endpoint: Change From Baseline in Quantity of Delandistrogene Moxeparvovec Dystrophin Protein Expression as Measured by Western Blot Adjusted by Muscle Content [Time Frame: Baseline, Week 12], Change From Baseline in Quantity of Delandistrogene Moxeparvovec Dystrophin Expression in Biopsied Muscle as Measured by Immunofluorescence (IF) Fiber Intensity [Time Frame: Baseline, Week 12], Change From Baseline in Quantity of Delandistrogene Moxeparvovec Dystrophin Expression in Biopsied Muscle as Measured by IF Percent Dystrophin-positive Fibers (PDPF) [Time Frame: Baseline, Week 12], Mean Concentration of Vector Genome Copies Using Polymerase Chain Reaction in Muscle Tissue Biopsy, After Delandistrogene Moxeparvovec Administration [Time Frame: Week 12]
Endpoint(s): Maximum Observed Plasma Concentration (Cmax) of Imlifidase [Time Frame: Up to Day 7], Total IgG in Serum After Imlifidase Administration [Time Frame: Up to Week 12], rAAVrh74 Antibody Titers After Imlifidase Administration [Time Frame: Up to Hour 120], Concentration of Vector Genome Copies Using Polymerase Chain Reaction in Serum, After Delandistrogene Moxeparvovec Administration [Time Frame: Up to Day 7], Number of Participants with a Treatment Emergent Adverse Event (TEAE), Adverse Event of Special Interest (AESI), and Serious Adverse Event (SAE) [Time Frame: Up to Week 104]

Source: https://euclinicaltrials.eu/ctis-public/view/2024-512624-11-00